EU clinical trial 2022-500674-34-00: Copanlisib and Rituximab in Marginal Zone Lymphoma Patients - A MULTICENTER OPEN LABEL SINGLE-ARM PHASE II STUDY (COUP-1)
Protocol code: COUP-1
Sponsor: University Hospital Of Ulm AöR (Hospital/Clinic/Other health care facility). Phase: Therapeutic exploratory (Phase II). Countries: Germany (ongoing, recruitment ended).
Therapeutic area(s): Diseases [C] - Hemic and Lymphatic Diseases [C15]
Gender: Female, Male. Age: 18-64 years, 65+ years. Enrolment: 36.
Status: Ongoing, recruitment ended. Start date (EU): 2019-11-04. Decision date: 2024-09-12. Results received: No. Last updated: 2026-02-09.

Condition(s): Marginal Zone Lymphoma
Product: Truxima 100 mg concentrate for solution for infusion, Truxima 500 mg concentrate for solution for infusion, BAY 80-6946

Primary endpoint: Primary endpoint is the complete response (CR rate (CRR) determined 12 months after start of induction therapy, i.e. month 6 of maintenance). Patients who progress before 12 months after start of treatment will be treated as CR=’NO’ and will be included in the calculation of the primary endpoint. No primary endpoint will be determined for patients who withdraw.
Endpoint(s): Response rate: The response rates (complete response (CR), partial response (PR)) and overall response rate (CR or PR) are evaluated 4 weeks after the end of induction treatment and 12 months after start of treatment., Best response: Best response is determined in the time interval from the start of induction therapy to end of follow-up., Time to best response: Time to best response is defined as the time from the start of induction to best response the patient achieves (CR, PR)., Time to first response: Time to first response is defined as the time from the start of induction to first response (CR, PR)., Progression free survival (PFS): Progression free survival (PFS) is defined as the time from registration to the first occurrence of progression or relapse as assessed by the investigator, or death from any cause. PFS for patients without disease progression, relapse, or death will be censored at the time of the last tumor assessment., Time to treatment failure (TTF): Time to treatment failure (TTF) is defined as the time of registration to discontinuation of therapy for any reason including death from any cause, progression, toxicity or add on of new anti-cancer therapy. Patients alive without treatment failure are censored at the latest tumor assessment date., Duration of Response (DR): Duration of response as defined as the period from the first response (at least PR) to treatment until evidence of disease progression, relapse or death of any cause. Patients alive without progression and relapse will be censored at the latest tumor assessment date or the stopping date., Cause specific survival (CSS): Cause specific survival is defined as the period from the induction registration to death from lymphoma or lymphoma related cause; death unrelated to MZL is considered as a competing event., Overall survival (OS): Overall survival is defined as the period from the induction registration to death from any cause. Patients who have not died until the time of the analysis will be censored at their last contact date., Quality of life during induction and maintenance therapy: Quality of life will be measured by the FACT-Lym (see Appendix H) before start of treatment, during induction and maintenance.

Source: https://euclinicaltrials.eu/ctis-public/view/2022-500674-34-00